EU clinical trial 2024-513687-26-00: Anti-GD2 ADC M3554 in Advanced Solid Tumors
Protocol code: MS201460_0001
Sponsor: Merck Healthcare KGaA (Pharmaceutical company). Phase: Human Pharmacology (Phase I)- First administration to humans. Countries: France (ongoing, recruiting), Belgium (ongoing, recruiting).
Therapeutic area(s): Diseases [C] - Neoplasms [C04]
Gender: Female, Male. Age: 18-64 years, 65+ years. Enrolment: 26.
Status: Ongoing, recruiting. Start date (EU): 2025-02-25. Decision date: 2024-11-26. Results received: No. Last updated: 2026-03-31.
Decision dates by country: BE: 2024-11-26, FR: 2024-11-27

Condition(s): Advanced Solid Tumors

Source: https://euclinicaltrials.eu/ctis-public/view/2024-513687-26-00